EU clinical trial 2024-512352-38-00: A phase 2, single-blinded, randomised, controlled multi-country study to evaluate the safety, reactogenicity, efficacy and immune response following sequential treatment with an anti-sense oligonucleotide (ASO) against chronic Hepatitis B (CHB) followed by chronic Hepatitis B targeted immunotherapy (CHB-TI) in CHB patients receiving nucleos(t)ide analogue (NA) therapy.
Protocol code: 217023
Sponsor: GlaxoSmithKline Biologicals (Pharmaceutical company). Phase: Therapeutic exploratory (Phase II). Countries: Belgium (ended), Italy (ended), Germany (ended), Romania (ended), France (ended), Spain (ended), Bulgaria (ended), Poland (ended).
Therapeutic area(s): Diseases [C] - Virus Diseases [C02]
Gender: Female, Male. Age: 18-64 years. Enrolment: 96.
Status: Ended. Start date (EU): 2019-03-28. End date (EU): 2025-08-29. End date: 2025-08-30. Decision date: 2024-05-08. Results received: Yes. Last updated: 2025-07-25.
Decision dates by country: BE: 2024-05-14, DE: 2024-05-10, IT: 2024-05-13, PL: 2024-05-31, RO: 2024-05-10, ES: 2024-05-08, BG: 2024-06-18, FR: 2024-05-14

Condition(s): Hepatitis B, Chronic
Product: Buffer S9b Solution for suspension for injection

Primary endpoint: "Safety • Percentage of participants reporting any grade 3 AE from first dose of GSK3228836 up to the study end. • Percentage of participants reporting any SAE from first dose of GSK3228836 up to the study end ", "• Percentage of participants reporting any AESIs grade 3 or higher from first dose of GSK3228836 up to the study end. ", "Efficacy • Percentage of participants who achieve SVR (HBsAg , • Difference between treatment arms (corresponding GSK3228836 regimens) in percentage of participants who achieve SVR (HBsAg < LLOQ and HBV DNA
Endpoint(s): "Solicited events post GSK3528869A • Percentage of participants reporting each injection site solicited adverse event (injection site redness, pain and swelling) within 7 days (Day 1 – Day 7) post administration of each dose of study treatment ", "• Percentage of participants reporting each systemic solicited adverse event within 7 days (Day 1 – Day 7) post administration of each dose of study treatment. ", "Unsolicited AEs • Percentage of participants reporting any unsolicited AE within 30 days (Day 1 – Day 30) post administration of each dose of GSK3528869A. ", "• Percentage of participants reporting any AE from first dose of GSK3228836 up to study end • Percentage of participants reporting any AESIs from first dose of GSK3228836 up to study end ", "pIMDs • Percentage of participants reporting any pIMDs anytime from first dose of GSK3528869A up to study end. ", "Safety laboratory assessments • Percentage of participants reporting haematological, biochemical or urinalysis laboratory abnormalities anytime from first dose of GSK3228836 up to the study end. ", "Efficacy • qHBsAg: number of participants with ≥0.5 log decrease, ≥1-log decrease, HBsAg loss and log-changes from baseline. • Number of participants with HBsAg loss and anti-HBs seroconversion. • Mean qHBsAg. ", "• Duration of SVR o Time to the first occurrence of HBsAg reversion. o Time to the first occurrence of HBV DNA reversion. ", "• Virologic breakthrough: HBV DNA ≥ 1-log increase from nadir or HBV DNA becoming quantifiable after being below the LLOQ. ", "Immunogenicity • Immunogenicity with respect to HBV components of GSK3528869A, at pre-defined time points. o Anti-HBc antibodies: responder rates and concentration ", "o Anti-HBs antibodies: seroconversion4, responder rates and concentration; anti-HBs ≥10 mIU/mL and ≥100 mIU/mL o Frequency of HBc- and HBs- specific CD4+ T-cell and CD8+ T-cell; CD4+ T-cells responders, CD8+ T-cell responders."

Source: https://euclinicaltrials.eu/ctis-public/view/2024-512352-38-00